EU clinical trial 2023-510092-62-00: An open-label single arm interventional phase 2 study to investigate outcome of individualized treatment based on pharmacogenomic profiling and ex vivo drug sensitivity testing of patient-derived organoids in patients with metastatic colorectal cancer
Protocol code: 2020-01-v2
Sponsor: Oslo University Hospital HF (Hospital/Clinic/Other health care facility). Phase: Therapeutic exploratory (Phase II). Countries: Norway (ongoing, recruiting).
Therapeutic area(s): Diseases [C] - Digestive System Diseases [C06]
Gender: Female, Male. Age: 18-64 years, 65+ years. Enrolment: 45.
Status: Ongoing, recruiting. Start date (EU): 2022-09-27. Decision date: 2024-05-16. Results received: No. Last updated: 2026-07-17.

Condition(s): Colorectal cancer
Product: Methotrexat Accord 25 mg/ml injeksjonsvæske, oppløsning, Herceptin 150 mg powder for concentrate for solution for infusion, Alecensa 150 mg hard capsules, Afinitor 10 mg tablets, Talzenna 0.1 mg hard capsules, Venclyxto 10 mg film-coated tablets, Mektovi 15 mg film-coated tablets, Gemcitabine Accord 100 mg/ml konsentrat til infusjonsvæske, KEYTRUDA 25 mg/mL concentrate for solution for infusion, Zydelig 100 mg film-coated tablets, IBRANCE 100 mg hard capsules, SPRYCEL 20 mg film-coated tablets, Farydak 20 mg hard capsules, XALKORI 250 mg hard capsules, Perjeta 420 mg concentrate for solution for infusion

Primary endpoint: Pre-screening: Number of patients from whom organoids and a full combined pharmacogenomic profiling were established and eligible for considering an MTBnominated treatment provided in the Main Study, Main study: Objective response rate (ORR) is a confirmed complete response (CR) or partial response (PR). • ORR in the total population. • ORR in each study drug cohort
Endpoint(s): Pre-screening: Number of patients from whom organoids and a full combined pharmacogenomic profile was established and eligible to have suggested: • An MTB-nominated treatment provided in the Main Study. • An MTB-nominated treatment considered as SOC. • An MTB-nominated treatment not considered as SOC and not provided in the Main Study. • No MTB-nominated treatment, Pre-screening: • Registered outcome of all systemic SOC oncological treatment; objective response (OR), PFS and DOR. • OS from start of firstline SOC chemotherapy and OS from start of each line of SOC treatment, Main study: • PFS, defined as the time from the first dose of the MTB-nominated treatment to the first documented disease progression or death due to any cause, whichever occurs first. • DOR, defined as the time from the first documented evidence of CR or PR until progressive disease (PD) or death due to any cause, whichever occurs first, in participants demonstrating CR or PR, Main study: OS, defined as the time from the first dose of MTB-nominated treatment to the date of death from any cause. • Classify and register adverse vents., Main study: • Assess ORR, DOR, PFS of MTB-nominated treatment and from the previous line of SOC treatment regimen in each patient. • Assess the number of patients who have a PFS of the MTB-nominated treatment which is >1.3 x PFS of the previous line of therapy., Main study: Assess ORR, DOR, PFS and of MTB-nominated treatment and form anticancer therapy in the next/later lines of SOC treatment in each patient, Main study: Patient-reported outcome measures

Source: https://euclinicaltrials.eu/ctis-public/view/2023-510092-62-00